EU clinical trial 2025-521173-13-00: First-in-Human Trial of DS3610a in Participants with Advanced Solid Tumors
Protocol code: DS3610-071
Sponsor: Daiichi Sankyo Inc. (Pharmaceutical company). Phase: Human Pharmacology (Phase I)- First administration to humans. Countries: France (authorised, recruiting), Spain (authorised, recruitment pending).
Therapeutic area(s): Diseases [C] - Neoplasms [C04]
Gender: Female, Male. Age: 18-64 years, 65+ years. Enrolment: 24.
Start date (EU): 2026-07-01. Decision date: 2026-05-08. Results received: No. Last updated: 2026-05-11.
Decision dates by country: FR: 2026-05-11, ES: 2026-05-08

Condition(s): Advanced Solid Tumors

Source: https://euclinicaltrials.eu/ctis-public/view/2025-521173-13-00